EU clinical trial 2022-503016-16-00: A double-blind, randomized, placebo-controlled trial to test the efficacy, safety and tolerability of Dimethyl Fumarate in Friedreich Ataxia (DMF-FA-201).
Protocol code: DMF-FA-201
Sponsor: Dipartimento Di Neuroscienze E Scienze Riproduttive Ed Odontostomatologiche Universita Degli Studi Di Napoli Federico II (Educational Institution). Phase: Therapeutic exploratory (Phase II). Countries: Italy (ongoing, recruitment ended).
Therapeutic area(s): Diseases [C] - Nervous System Diseases [C10]
Gender: Female, Male. Age: 0-17 years, 18-64 years, 65+ years. Enrolment: 40.
Status: Ongoing, recruitment ended. Start date (EU): 2023-11-10. Decision date: 2023-05-03. Results received: No. Last updated: 2026-05-29.

Condition(s): Friedreich's Ataxia
Product: Skilarence 120 mg gastro-resistant tablets, Placebo of Dimethyl fumarate 120 mg gastro-resistant tablets

Primary endpoint: The effect of DMF compared to placebo on one of two co-primary endpoints (achievement of one out of two is a positive result): FXN gene expression and frataxin protein level. For both we will consider the change from baseline to 12 weeks (core phase of the DMF-FA-201 study).
Endpoint(s): Effect of DMF on the cardiopulmonary exercise outputs (VO2max, anaerobic threshold, peak workload), Effect of DMF on echocardiographic measures, Effect of DMF on FXN and frataxin protein from pooled data from the core and extension phase of the study, Effect of DMF on FXN and frataxin protein at week 4 of the core phase, Effect of DMF on Nrf2 pathway genes: NFE2L2, NQO1, HMOX1, PDLIM1, NCF2, Effect of DMF on mitochondrial biogenesis genes (mt-ND6, mtCYB, mt-CO2, mt-ATP6) and on mtDNA/nDNA, Number and distribution of serious and non-serious adverse events between DMF and placebo, Difference in the Scale for the Rating and assessment of Ataxia (SARA) and modified Friedreich Ataxia Rating Scale (mFARS) between DMF and placebo, Difference in the 9-hole pegboard test (9HPT) between DMF and placebo, Difference in the EQ-5D and ADL/IADL between DMF and placebo

Source: https://euclinicaltrials.eu/ctis-public/view/2022-503016-16-00